EU clinical trial 2024-518146-25-00: SPironolactONe for the maintenance of Sinus Rhythm in hypertensive patients with atrial fibrillation and preserved left ventricular ejection fraction: a Prospective Randomized Open Blinded End-point (PROBE) multicenter study (SPONSoR study).
Protocol code: 20-197
Sponsor: Centre Hospitalier Universitaire De Caen Normandie (Hospital/Clinic/Other health care facility). Phase: Therapeutic confirmatory (Phase III). Countries: France (authorised, recruitment pending).
Therapeutic area(s): Diseases [C] - Cardiovascular Diseases [C14]
Gender: Female, Male. Age: 18-64 years. Enrolment: 580.
Status: Authorised, recruitment pending. Decision date: 2024-10-24. Results received: No. Last updated: 2024-10-24.

Condition(s): patients with atrial fibrillation and preserved left ventricular ejection fraction
Product: SPIRONOLACTONE PFIZER 25 mg, comprimé sécable

Primary endpoint: First documented recurrence of AF occurring from randomization and within 12 months, defined as an episode lasting for at least 30 sec documented on 12-leads ECG (planned or not) or on a wearable optical photoplethysmography (PPG) device (ScanWatch 42mm®, Withings)
Endpoint(s): The recurrence of symptomatic documented AF episodes from randomization and within 12 months, The delay (days) of recurrence of the first documented AF episode (symptomatic or not) during the follow-up, The cumulative AF burden defined as the percentage of time in irregular rhythm on the wearable optical photoplethysmography (PPG) device (ScanWatch 42mm®, Withings) from randomization and within 12 months, Composite of major cardiovascular events and death (death from any cause, stroke, heart failure, myocardial infarction) occurring from randomization and within 12 months, Occurrence of cerebral/systemic thrombo-embolic and bleeding events, Mean ventricular rate (beats per minute) at the recurrence of AF on 12-leads ECG (planned or not) or on a wearable optical photoplethysmography (PPG) device (ScanWatch 42mm®, Withings), Blood pressure-lowering efficacy evaluated on blood pressure measurements from randomization to 1, 6, and 12 months as assessed by office blood pressure, Safety endpoints: occurrence of low blood pressure, changes in serum potassium and acute kidney injury from randomization and within 12 months

Source: https://euclinicaltrials.eu/ctis-public/view/2024-518146-25-00